EU clinical trial 2025-523553-34-00: A Phase 1a/1b Study Evaluating the Safety, Tolerability, Pharmacokinetics, Pharmacodynamics and Preliminary Antitumor Activity of BG-75202, Alone and in Combination with Other Agents in Patients with Advanced Solid Tumors
Protocol code: BG-75202-101
Sponsor: BeOne Medicines I GmbH (Pharmaceutical company). Phase: Human Pharmacology (Phase I)- First administration to humans. Countries: Italy (ongoing, recruiting), Spain (ongoing, recruiting).
Therapeutic area(s): Diseases [C] - Neoplasms [C04]
Gender: Female, Male. Age: 18-64 years, 65+ years. Enrolment: 15.
Status: Ongoing, recruiting. Start date (EU): 2026-04-15. Decision date: 2026-03-12. Results received: No. Last updated: 2026-06-29.
Decision dates by country: IT: 2026-03-12, ES: 2026-03-12

Condition(s): Advanced and Metastatic Solid tumors

Source: https://euclinicaltrials.eu/ctis-public/view/2025-523553-34-00